EU clinical trial 2023-509679-17-00: Evaluation of the effect of a single dose of psilocybin on neural correlates of cognitive control in patients with CNEP (psychogenic nonepileptic seizures): a single-arm, open-label pilot study.
Protocol code: NIMAO/2022-2/IC-01
Sponsor: Centre Hospitalier Universitaire De Nimes (Hospital/Clinic/Other health care facility). Phase: Therapeutic exploratory (Phase II). Countries: France (ongoing, recruitment ended).
Therapeutic area(s): Psychiatry and Psychology [F] - Mental Disorders [F03]
Gender: Female, Male. Age: 18-64 years. Enrolment: 10.
Status: Ongoing, recruitment ended. Start date (EU): 2024-11-05. Decision date: 2024-05-22. Results received: No. Last updated: 2025-01-13.

Condition(s): psychogenic non-epileptic seizures
Product: PSILOCYBINE

Primary endpoint: Quantification of changes in the activity of the cognitive control network on functional brain MRI during an emotional Go-No Go task (described by Fauvé et al. (2022)) performed before (D-3) and after (D+5) psilocybin administration
Endpoint(s): Changes in brain activity on resting-state functional brain MRI of the cognitive control network before (D-3) and after (D+5) psilocybin administration., Changes in brain activity on resting-state MRI of the Default-Mode Network (DMN) before (D-3) and after (D+5) psilocybin administration., Collection of the number of errors (n) and measurement of response latency (ms) during an emotional Go-No Go task before (D-3) and after (D+5) psilocybin administration., Collection of the number of errors (n) and measurement of response latency (ms) during a neutral Go-No Go task before (D-3) and after (D+5) psilocybin administration., Measurement of the frequency of CNEP in the 6 weeks before and after psilocybin administration using a seizure diary., Measurement of changes in the CGI-CNEP scale before (D-3) and after (D+5, M1 and M3) psilocybin administration; scoring by the neurologist and psychiatrist., Measurement of changes in dissociative symptomatology using the DES scale before (D-45, D-3) and after (D+5, M1 and M3) psilocybin administration., Administration of the 5D-ASC (5-Dimensional Altered States of Consciousness Questionnaire) at D0 then D+5, M1 and M3 after psilocybin administration..

Source: https://euclinicaltrials.eu/ctis-public/view/2023-509679-17-00